EU clinical trial 2023-507332-20-00: A Phase I/II study of Vibrio alginolyticus collagenase in patients with Dupuytren contracture. A Phase I single ascending dose with a Phase II expansion, safety, tolerability, efficacy, pharmacokinetics and immunogenicity study
Protocol code: RR37_23_01
Sponsor: Fidia Farmaceutici S.p.A. (Pharmaceutical company). Phase: Phase I and Phase II (Integrated)- Other. Countries: Austria (ongoing, recruiting), Germany (ongoing, recruiting), Italy (ongoing, recruiting), Sweden (ongoing, recruiting).
Therapeutic area(s): Diseases [C] - Skin and Connective Tissue Diseases [C17]
Gender: Female, Male. Age: 18-64 years, 65+ years. Enrolment: 97.
Status: Ongoing, recruiting. Start date (EU): 2024-12-18. Decision date: 2024-10-16. Results received: No. Last updated: 2026-07-10.
Decision dates by country: AT: 2024-10-20, DE: 2024-10-16, SE: 2024-10-18, IT: 2024-10-16

Condition(s): Dupuytren contracture
Product: VIBRIO ALGINOLYTICUS COLLAGENASE, Vibrio alginolyticus collagenase matching placebo sterile lyophilised powder for injection

Primary endpoint: Primary endpoint in the Phase I part: Overall safety profile of each escalating dose of V. alginolyticus collagenase in order to identify the maximum tolerated dose in the absence of limiting toxicity as defined for the dose escalating process., Primary endpoint in the Phase II part: -Proportion of patients who achieve clinical success defined as a reduction in contracture to ≤5° in 30±3 days after the last injection of V. alginolyticus collagenase into the cord in the affected primary joint as measured by passive angle of finger extension as compared to matching placebo In the evaluation of each endpoint, MP and PIP joints will be evaluated cumulatively and separated.
Endpoint(s): Secondary endpoints in the Phase I part: - Proportion of patients who achieve a reduction in contracture to ≤5° (clinical success) as measured by passive finger goniometry 30±3 days after one injection of each tested ascending dose, Proportion of patients who have ≥50% reduction from baseline in contracture (clinical improvement) as measured by passive finger goniometry 30±3 days after one injection of each tested ascending dose, Percentage change from baseline in contracture degree as measured by passive finger goniometry 30±3 days after one injection of each tested single ascending dose, Percentage change from baseline in passive finger flexion 30±3 days after one injection of each tested dose, Change from baseline in the range of motion after injection of each tested single ascending dose, Secondary endpoints in the Phase II part: • Proportion of patients who achieve a clinical improvement defined as a reduction from baseline in contracture by ≥50% in 30±3 days after the last injection of V. alginolyticus collagenase into the cord in the affected primary joint as measured by passive angle of finger extension as compared to matching placebo, Mean number of injections of V. alginolyticus collagenase into the affected cord in the primary joint (MP or PIP) necessary to achieve clinical success as compared to matching placebo, Median time (in days) to achieve and maintain clinical success after the last injection of V. alginolyticus collagenase into the affected cord in the primary joint (MP or PIP) as compared to matching placebo, Percentage change from baseline in contracture degree as measured by passive finger extension in 30±3 days after the last injection of V. alginolyticus collagenase into the cord in the affected primary joint as compared to matching placebo, Percentage change from baseline in passive finger flexion in 30±3 days after the last injection of V. alginolyticus collagenase into the cord in the affected primary joint as compared to matching placebo, Change from baseline in the range of motion in 30±3 days after the last injection of V. alginolyticus collagenase into the cord in the affected primary joint as compared to matching placebo, Proportion of patients who achieve clinical success defined as a reduction in contracture to ≤5° in 30±3 days after each received injection of V. alginolyticus collagenase into the cord in the affected primary joint as measured by passive angle of finger extension as compared to matching placebo, Proportion of patients who achieve a clinical improvement defined as a reduction from baseline in contracture by ≥50% in 30±3 days after each received injection of V. alginolyticus collagenase into the cord in the affected primary joint as measured by passive angle of finger extension as compared to matching placebo, Secondary endpoints in both study parts: - Blood exposure after each injection of V. alginolyticus collagenase evaluated as serum levels of V. alginolyticus collagenase at pre-dose and 10 min, 0.5, 1, and 2 h post-dose, Immunogenicity of V. alginolyticus collagenase evaluated through assay of serum anti-drug antibodies in all subjects at pre-dose and 30±3 days post-dose, Overall safety profile of injection of V. alginolyticus collagenase or matching placebo, Follow-up endpoints: Percentage change from baseline in contracture degree as measured by passive finger extension 6 months after the last injection of V. alginolyticus collagenase into the cord in the affected primary joint as compared to matching placebo, Proportion of patients who have an increase in joint contracture to ≥20° in the presence of a palpable cord (recurrence) as measured by passive finger extension 6 months after the last injection of V. alginolyticus collagenase into the cord in the affected primary joint as compared to matching placebo, Percentage change from baseline in passive finger flexion 6 months after the last injection of V. alginolyticus collagenase into the cord in the affected primary joint as compared to matching placebo, Change from baseline to Month 6 in the range of motion after the last injection of V. alginolyticus collagenase into the cord in the affected primary joint as compared to matching placebo, Safety profile of injection of V. alginolyticus collagenase or matching placebo after 6 months, Immunogenicity of V. alginolyticus collagenase evaluated through assay of serum anti-drug antibodies in all subjects at Month 6 after the last injection

Source: https://euclinicaltrials.eu/ctis-public/view/2023-507332-20-00